EU clinical trial 2023-509257-31-00: Hero: A Study to Evaluate the Safety, Tolerability, and Pharmacokinetics (PK) of ION269 in Participants With Down Syndrome (DS) at Risk for Alzheimer’s Disease (AD)
Protocol code: ION269-CS1
Sponsor: Ionis Pharmaceuticals Inc. (Pharmaceutical company). Phase: Human Pharmacology (Phase I)- First administration to humans. Countries: Spain (ended).
Therapeutic area(s): Diseases [C] - Nervous System Diseases [C10]
Gender: Female, Male. Age: 18-64 years. Enrolment: 7.
Status: Ended. Start date (EU): 2025-02-12. End date (EU): 2025-08-21. End date: 2025-12-03. Decision date: 2024-10-10. Results received: No. Last updated: 2025-03-06.

Condition(s): Alzheimer’s Disease in Individuals with Down Syndrome

Source: https://euclinicaltrials.eu/ctis-public/view/2023-509257-31-00